EU clinical trial 2024-513660-26-00: A randomized trial of multi-factorial primary prevention in high risk subjects candidate to a lung cancer early detection CT program
Protocol code: SMILE
Sponsor: Fondazione IRCCS Istituto Nazionale Dei Tumori (Hospital/Clinic/Other health care facility). Phase: Therapeutic exploratory (Phase II). Countries: Italy (ongoing, recruiting).
Therapeutic area(s): Diseases [C] - Respiratory Tract Diseases [C08]; Diseases [C] - Pathological Conditions, Signs and Symptoms [C23]; Health Care [N] - Health Care Quality, Access, and Evaluation [N05]
Gender: Female, Male. Age: 18-64 years, 65+ years. Enrolment: 2000.
Status: Ongoing, recruiting. Start date (EU): 2024-08-06. Decision date: 2024-08-05. Results received: No. Last updated: 2024-08-05.

Condition(s): Subjects at high risk of inflammatory state and mortality from lung cancer, other cancers and all causes
Product: CARDIOASPIRIN 100 mg Compresse gastroresistenti, Tabex 1,5 mg tabletki powlekane

Primary endpoint: Reduction in the percentage of subjects with PCR ≥2 mg/L after one year of treatment in the interventional groups versus control group.
Endpoint(s): Reduction of the proportion of smokers after one year of follow-up in the intervention group on smoking cessation over the control group, Greater adherence to the Mediterranean Diet, measured through specific indexes defined in scientific literature (such as the MDS), The inflammatory status group with respect to the control group, Increased physical activity, quantified in terms of Metabolic Equivalence of the Task (MET) in the inflammatory response group compared to the control group, Reduction of the various anthropometric parameters (IMC, waist circumference, waist circumference / waist ratio) and greater prevalence of weight-weight subjects in the inflammatory intervention group versus the control group, Reduction of cardio-metabolic markers in the blood in the inflammatory group compared to the control group, Better quality of life, quantified by SF- 12 in intervention groups compared to control group, Reduction of the incidence rate of lung cancer in the intervention group on smoking cessation with respect to the control group, Reduction of the total mortality rate in the intervention groups compared to the control group, Evaluation of the relationship between inflammatory profile (PCR) plasma biomarkers and cardio-metabolic profile and microRNA profile, Reduction in percentage of smokers and adverse reactions after one year of follow-up in subjects treated with Cytisine with prolonged administration compared to standard drug administration

Source: https://euclinicaltrials.eu/ctis-public/view/2024-513660-26-00